EU clinical trial 2024-513269-37-00: C4951004 - BHV3000-406: A Phase 4, Randomized, Double-blind Placebo Controlled, Efficacy and Tolerability Trial of Rimegepant for the Acute Treatment of Migraine in Adults Unsuitable for Triptan Use
Protocol code: C4951004/BHV3000-406
Sponsor: Pfizer Inc. (Pharmaceutical company). Phase: Therapeutic use (Phase IV). Countries: Finland (ended), Germany (ended), Sweden (ended), Austria (ended), Belgium (ended), France (ended), Poland (ended), Denmark (ended), Italy (ended), Spain (ended).
Therapeutic area(s): Diseases [C] - Nervous System Diseases [C10]
Gender: Female, Male. Age: 18-64 years, 65+ years. Enrolment: 397.
Status: Ended. Start date (EU): 2023-03-14. End date (EU): 2025-06-05. End date: 2025-06-10. Decision date: 2024-08-02. Results received: Yes. Last updated: 2025-04-11.
Decision dates by country: FI: 2024-08-05, DE: 2024-08-02, ES: 2024-08-07, DK: 2024-08-03, SE: 2024-08-02, AT: 2024-08-07, FR: 2024-08-05, IT: 2024-08-19, BE: 2024-08-02, PL: 2024-08-04

Condition(s): Migraine attacks with or without aura
Product: VYDURA 75 mg oral lyophilisate, Placebo for Rimegepant 75 mg

Primary endpoint: Percentage of subjects with a headache pain intensity of none or mild at 2 hours postdose in the DBT Phase. Migraine headache pain intensity will be measured on a 4-point numeric rating scale (0=none, 1=mild, 2=moderate, 3=severe).
Endpoint(s): Percentage of subjects with a headache pain intensity of none at 2 hours postdose in the DBT Phase., Percentage of subjects who take rescue medication within 24 hours after taking study drug in the DBT Phase., Percentage of subjects with a functional disability level of normal at 2 hours postdose in the DBT Phase in the subset of subjects with functional disability at the time of dosing. Functional disability level will be measured on a 4-point numeric rating scale (0=normal, 1=mildly impaired, 2=severely impaired, 3=requires bedrest)., Percentage of subjects with functional disability levels of normal at all time points from 2 to 24 hours postdose in the DBT Phase in the subset of subjects with functional disability at the time of dosing., Percentage of subjects with functional disability levels of normal at all time points from 2 to 48 hours postdose in the DBT Phase in the subset of subjects with functional disability at the time of dosing., Percentage of subjects with headache pain intensities of none or mild at all time points from 2 to 24 hours postdose in the DBT Phase., Percentage of subjects with headache pain intensities of none or mild at all time points from 2 to 48 hours postdose in the DBT Phase., Percentage of subjects with headache pain intensities of none at all time points from 2 to 24 hours postdose in the DBT Phase., Percentage of subjects with headache pain intensities of none at all time points from 2 to 48 hours postdose in the DBT Phase., Percentage of subjects with an MBS that is reported on study before dosing and is absent at 2 hours postdose in the DBT Phase. The MBS on study before dosing will be reported as nausea, phonophobia, or photophobia. Symptom status will be reported postdose as present or absent for each symptom (nausea, phonophobia, and photophobia).

Source: https://euclinicaltrials.eu/ctis-public/view/2024-513269-37-00